EU clinical trial 2023-509635-89-00: A Phase 1b/2 Study of BMS-986158 Monotherapy and in Combination with Either Ruxolitinib or Fedratinib in Participants with DIPSS-Intermediate or High Risk Myelofibrosis
Protocol code: CA011-023
Sponsor: Bristol-Myers Squibb Services Unlimited Company (Pharmaceutical company). Phase: Phase I and Phase II (Integrated)- Other. Countries: Germany (ended), Spain (ended), Romania (ongoing, recruitment ended), Greece (ended), Poland (ongoing, recruitment ended), France (ongoing, recruitment ended), Italy (ended).
Therapeutic area(s): Diseases [C] - Neoplasms [C04]
Gender: Female, Male. Age: 18-64 years, 65+ years. Enrolment: 108.
Start date (EU): 2021-06-01. Decision date: 2024-01-18. Results received: No. Last updated: 2026-05-04.
Decision dates by country: GR: 2024-02-27, ES: 2024-01-18, IT: 2024-01-22, DE: 2024-02-01, FR: 2024-01-23, RO: 2024-04-19, PL: 2024-01-29

Condition(s): DIPSS-Intermediate or High Risk Myelofibrosis
Product: BET-Inhibitor, Jakavi 5 mg tablets, Jakavi 10 mg tablets, Jakavi 15 mg tablets, FEDRATINIB

Primary endpoint: Incidence of Adverse Events (AEs), Serious Adverse Events (SAEs), Dose Limiting Toxicity (DLT), and AEs leading to discontinuation and death.
Endpoint(s): ≥ 35% reduction in Spleen Volume Response measured by MRI or CT at the end of cycle 6 as assessed by central reader, ≥ 25% reduction in Spleen Volume Response measured by MRI or CT at the end of cycle 3 and 6 as assessed by central reader, ≥ 50% reduction in Total Symptom Score measured by MF Symptom Assessment Form (MFSAF) at the end of cycle 6

Source: https://euclinicaltrials.eu/ctis-public/view/2023-509635-89-00